EU clinical trial 2023-503333-22-00: A 12-week double-blind, multicentre, randomised, active-controlled, 2-arm, parallel-group clinical trial to evaluate the safety of CHF5993 pMDI 200/6/12.5 µg HFA-152a, compared to CHF5993 pMDI 200/6/12.5 µg HFA-134a, in subjects with asthma
Protocol code: CLI-05993AB6-03
Sponsor: Chiesi Farmaceutici S.p.A. (Pharmaceutical company). Phase: Therapeutic confirmatory (Phase III). Countries: Poland (ended), Germany (ended), Bulgaria (ended), Czechia (ended), Greece (ended), Hungary (ended), Italy (ended), Romania (ended), Spain (ended), Netherlands (ended), Slovakia (ended).
Therapeutic area(s): Diseases [C] - Respiratory Tract Diseases [C08]
Gender: Female, Male. Age: 18-64 years, 65+ years. Enrolment: 677.
Status: Ended. Start date (EU): 2024-01-15. End date (EU): 2025-02-24. End date: 2026-02-25. Decision date: 2023-11-10. Results received: Yes. Last updated: 2025-09-25.
Decision dates by country: GR: 2024-04-15, HU: 2024-04-15, RO: 2024-03-11, SK: 2024-04-08, NL: 2024-04-15, IT: 2024-04-10, CZ: 2024-04-11, BG: 2023-11-20, PL: 2023-11-15, ES: 2024-05-31, DE: 2023-11-10

Condition(s): Moderate to severe controlled asthma according to Step 4 and Step 5 of the Global Initiative for Asthma (GINA) 2022 Guidelines.
Product: SALBUTAMOL, Trimbow 172 micrograms/5 micrograms/9 micrograms pressurised inhalation, solution

Primary endpoint: Relative change from pre-dose* in FEV1 at the 10 min post‑dose timepoint on Day 1.
Endpoint(s): Relative change from pre-dose* in FEV1 at all the post-dose timepoints at each study visit (Day 1, Day 7 and Week 12: 20 min, 30 min, 1 h and 2 h post-dose; Day 7, Week 4 and Week 12: 10 min post-dose);, Absolute change from pre-dose* in FEV1 at all post-dose timepoints at each study visit (Day 1, Day 7, and Week 12: 10 min, 20 min, 30 min, 1 h, and 2 h post-dose; Week 4: 10 min post-dose);, Number and percentage of subjects with a relative decrease from pre-dose* in FEV1 at each post-dose timepoint and at any post-dose timepoint > 15% at each study visit (Day 1, Day 7, and Week 12: 10 min, 20 min, 30 min, 1 h, and 2 h post-dose; Week 4: 10 min post-dose);, Absolute and relative changes from baseline (i.e., pre-dose* FEV1 at Day 1) in pre-dose* FEV1 at all clinical visits;, Change from pre-dose* in FEV1 area under the curve from time zero to 2 h (AUC0-2h) on Day 1, Day 7 and Week 12;, Change from baseline at each inter-visit period and over the entire treatment period in morning and evening PEF;, Change from baseline at each inter-visit period and over the entire treatment period in the percentage of days without intake of rescue medication;, Change from baseline at each inter-visit period and over the entire treatment period in the average daily use of rescue medication (number of inhalations/day);, Change from baseline at each inter-visit period and over the entire treatment period in the average daily symptoms, Change from baseline in ACQ-7 at each study visit;, AEs and adverse drug reactions (ADRs);, AEs of particular interest: cough, dysphonia, paradoxical bronchospasm, hypersensitivity reactions, severe asthma exacerbations according to ATS/ERS criteria, Vital signs (systolic and diastolic blood pressure);, 12-lead ECG parameters: heart rate (HR), QTcF, PR interval (PR) and QRS interval (QRS);, 12-lead ECG abnormalities, Standard haematology and blood chemistry (including serum potassium and glucose);, Chemistry in urine (quantitative [proteins] and qualitative [ketones and microscopic examination of the sediments]).

Source: https://euclinicaltrials.eu/ctis-public/view/2023-503333-22-00